EU clinical trial 2022-502845-83-00: A PHASE 2A, INVESTIGATOR AND SUBJECT BLINDED, SPONSOR UNBLINDED, PLACEBO-CONTROLLED, CLINICAL STUDY TO EVALUATE THE SAFETY, TOLERABILITY, PHARMACOKINETICS, AND PHARMACODYNAMICS OF CRD-4730 IN PARTICIPANTS WITH CATECHOLAMINERGIC POLYMORPHIC VENTRICULAR TACHYCARDIA
Protocol code: CRD-4730-201
Sponsor: Cardurion Pharmaceuticals Inc. (Pharmaceutical company). Phase: Therapeutic exploratory (Phase II). Countries: France (ended), Italy (ended).
Therapeutic area(s): Diseases [C] - Cardiovascular Diseases [C14]
Gender: Female, Male. Age: 18-64 years, 65+ years. Enrolment: 5.
Status: Ended. Start date (EU): 2024-04-15. End date (EU): 2025-05-31. Decision date: 2024-03-14. Results received: Yes. Last updated: 2025-03-21.
Decision dates by country: FR: 2024-03-15, IT: 2024-03-14

Condition(s): Catecholaminergic Polymorphic Ventricular Tachycardia (CPVT)
Product: CRD-4730, Encapsulation of microcrystalline cellulose into HPMC capsules to match the CRD-4730 active capsules in appearance

Primary endpoint: Adverse events, clinical laboratory test results (hematology, serum chemistry, and urinalysis), vital sign measurements, and 12-lead electrocardiogram (ECG) results, and physical examination findings
Endpoint(s): Change in ventricular arrhythmia (VA) score from baseline to Day 1, from baseline to Day 8, and from baseline to Day 15, Plasma concentrations of CRD-4730 over time for each treatment period

Source: https://euclinicaltrials.eu/ctis-public/view/2022-502845-83-00